EU clinical trial 2025-521581-10-00: A Phase 1/2 First-Time-in-Human, open-label, multicenter, dose escalation and expansion study of GSK5458514 PSMA targeting T cell engager alone or in combination with other anti-cancer agents in adult participants with metastatic castration-resistant prostate cancer (mCRPC)
Protocol code: 223050
Sponsor: Glaxosmithkline Research & Development Limited (Pharmaceutical company). Phase: Phase I and Phase II (Integrated)- First administration to humans. Countries: France (ongoing, recruiting), Spain (ongoing, recruiting).
Therapeutic area(s): Diseases [C] - Neoplasms [C04]
Gender: Male. Age: 18-64 years, 65+ years. Enrolment: 20.
Status: Ongoing, recruiting. Start date (EU): 2026-01-16. Decision date: 2025-11-03. Results received: No. Last updated: 2026-02-18.
Decision dates by country: FR: 2025-11-03, ES: 2025-11-13

Condition(s): Neoplasms, Prostate

Primary endpoint: Number of participants with dose limiting toxicities (DLTs) during DLT observation period, Number of participants with adverse events (AEs), serious adverse events (SAEs), by Severity, Number of participants with AEs leading to dose modifications
Endpoint(s): GSK5458514 PK parameters following IV dose administration, as data permit - Area under concentration from 0 to t (AUC 0‑t) of GSK5458514 - Maximum concentration (Cmax) of GSK5458514, Number of participants with Anti-drug antibodies (ADA) against GSK5458514, Titers of Anti-drug antibodies (ADA) against GSK5458514, Prostate-specific antigen decrease from baseline >=50% (PSA50) Response Rate, Objective Response Rate (ORR)

Source: https://euclinicaltrials.eu/ctis-public/view/2025-521581-10-00